EU clinical trial 2024-515528-35-00: Pharmacokinetic-guided dosing of emicizumab in congenital haemophilia A patients – The DosEmi study
Protocol code: 22-571/21U-0151
Sponsor: Universitair Medisch Centrum Utrecht (Hospital/Clinic/Other health care facility). Phase: Phase III and phase IV (Integrated). Countries: Netherlands (ongoing, recruiting).
Therapeutic area(s): Diseases [C] - Hemic and Lymphatic Diseases [C15]
Gender: Male. Age: 0-17 years, 18-64 years, 65+ years. Enrolment: 135.
Status: Ongoing, recruiting. Start date (EU): 2022-09-08. Decision date: 2024-06-28. Results received: No. Last updated: 2026-02-11.

Condition(s): Congenital Haemophilia A
Product: Hemlibra 150 mg/mL solution for injection, Hemlibra 30 mg/mL solution for injection, Hemlibra 30 mg/mL solution for injection, Hemlibra 150 mg/mL solution for injection, Hemlibra 150 mg/mL solution for injection, Hemlibra 150 mg/mL solution for injection

Primary endpoint: Proportion of patients without treated bleeds (6 months Bleeding Assessment Phase versus 6 months PK-Guided Dosing Phase).
Endpoint(s): Proportion of patients without treated bleeds (12 months Clinical Phase+Bleeding Assessment Phase versus 12 months PK-guided Dosing Phase+Dose Continuation Phase), Proportion of patients with spontaneous joint- or muscle bleeds (6 and 12 months Clinical Phase+Bleeding Assessment Phase versus 6 and 12 months PK-guided Dosing Phase+Dose Continuation Phase)., Annualized bleeding rate (ABR) of treated bleeds, including joint bleeds and sports induced bleeds (6 months Bleeding Assessment Phase versus 6 months PK-Guided Dosing Phase)., Annualized bleeding rate (ABR) of treated bleeds, including joint bleeds and sports induced bleeds (6 months retrospective + 6 months prospective data (Clinical Phase+Bleeding Assessment Phase) versus 12 months prospective data of PK guided dosing (PK-guided Dosing Phase+Dose Continuation Phase)., Cost-effectiveness between 6 months of conventional dosing (Bleeding Assessment Phase) and 6 months of individualized PK-guided dosing of emicizumab (PK-Guided Dosing Phase), further details see protocol, Predictive performance of the MAP Bayesian procedure used for the dose adaptation procedure, defined as % of patients within ±20% of target level/within the target level of 25-39 µg/mL of emicizumab. All emicizumab plasma levels will be determined in the laboratory of the University Medical Center Utrecht using a specifically developed LCMS/MS, Joint status as measured by physical examination (Haemophilia Joint Health Score; HJHS), ultrasound (if available, according to the HEAD US score) and biomarkers of bone and cartilage turnover., Health related quality of life will be assessed with EQ5D(Y) (5 questions), and PROMIS instruments (Physical Function/mobility and Pain Interference short forms) (8 questions each)., Assessment of pain during emicizumab administration by Visual Analogue Scale (VAS)., Assessment of the cumulative number of sc. and/or iv. Injections related to coagulation correction., Sports participation (type, duration, frequency) will be assessed with Modifiable Activities Questionnaire (MAQ)., Plasma coagulation potential will be measured with thrombin generation tests as a potential read-out for pharmacodynamics.

Source: https://euclinicaltrials.eu/ctis-public/view/2024-515528-35-00